EU clinical trial 2023-505870-13-00: DAREON™-7: A study to test how well different doses of BI 764532 in addition to chemotherapy are tolerated by people with advanced neuroendocrine cancers
Protocol code: 1438-0007
Sponsor: Boehringer Ingelheim International GmbH (Pharmaceutical company). Phase: Human Pharmacology (Phase I)- Other. Countries: Spain (ongoing, recruitment ended), Belgium (ongoing, recruitment ended), Germany (ended), France (ongoing, recruitment ended), Sweden (ongoing, recruitment ended), Netherlands (ongoing, recruitment ended).
Therapeutic area(s): Diseases [C] - Neoplasms [C04]
Gender: Female, Male. Age: 18-64 years, 65+ years. Enrolment: 35.
Start date (EU): 2024-01-11. Decision date: 2023-11-20. Results received: No. Last updated: 2026-02-23.
Decision dates by country: BE: 2023-11-20, NL: 2025-01-15, DE: 2023-11-21, ES: 2023-11-20, SE: 2024-12-13, FR: 2023-11-22

Condition(s): Extra-pulmonary neuroendocrine carcinoma (epNEC), Neuroendocrine carcinoma (NEC) with unknown primary site, pulmonary Large cell neuroendocrine carcinoma (LCNEC)

Source: https://euclinicaltrials.eu/ctis-public/view/2023-505870-13-00